EU clinical trial 2023-509469-19-00: A non-randomised, open-label, uncontrolled, multi-centre, phase IIIb study evaluating the safety and efficacy of fluocinolone acetonide 190 micrograms intravitreal implant in paediatric subjects from 6 years to less than 18 years with recurrent non-infectious uveitis affecting the posterior segment of the eye.
Protocol code: ALI-P01-21-006
Sponsor: Alimera Sciences Europe Limited (Pharmaceutical company). Phase: Phase III and phase IV (Integrated). Countries: Germany (authorised, recruiting), Spain (authorised, recruiting).
Therapeutic area(s): Diseases [C] - Eye Diseases [C11]
Gender: Female, Male. Age: 0-17 years. Enrolment: 10.
Status: Authorised, recruiting. Start date (EU): 2024-04-17. Decision date: 2024-06-25. Results received: No. Last updated: 2026-04-30.
Decision dates by country: DE: 2024-06-27, ES: 2024-06-25

Condition(s): Non-Infectious Uveitis affecting the posterior segment
Product: ILUVIEN 190 micrograms intravitreal implant in applicator.

Primary endpoint: Treatment success based on: 1. Absence of cystoid macular oedema on Optical Coherence Tomography AND 2. A decrease from baseline in vitreous haze grade ≥2 steps, or absence of vitreous haze, Rate of cataract formation, Rate of IOP elevation (Change from baseline in IOP and incidence of significant changes in IOP, including: IOP>21 mmHg, IOP>25 mmHg IOP>30 mmHg, increases from baseline of 10 mmHg or more).
Endpoint(s): Absence of cystoid macular oedema and decrease from baseline in vitreous haze grade of ≥2 steps, or absence of vitreous haze at completion of the study, Uveitis recurrence rate following treatment, compared to the uveitis recurrence rate over the 12 months prior to enrolment, The incidence of recurrence of non-infectious uveitis affecting the posterior segment in the study eye and in the fellow eye after receiving study treatment, The time to recurrence of non-infectious uveitis affecting the posterior segment in the study eye, Change in macular oedema, Change in Best Corrected Visual Acuity, Change in vitreous haze, Change in anterior chamber cell grade, Incidence of secondary increase in IOP, Incidence of secondary increase in IOP requiring surgical intervention, Incidence and onset of secondary lens opacity and extraction, Number of adjunctive treatments required to treat recurrences of uveitis, Presence of active chorioretinal and retinal vascular lesions, Incidence of ocular infection, Change from baseline in cup-to-disc ratio, Incidence of ocular and non-ocular adverse events (AEs)

Source: https://euclinicaltrials.eu/ctis-public/view/2023-509469-19-00